EU clinical trial 2022-502231-19-00: C4891023 - TACTIVE-U: AN INTERVENTIONAL SAFETY AND EFFICACY PHASE 1B/2, OPEN-LABEL UMBRELLA STUDY TO INVESTIGATE TOLERABILITY, PK, AND ANTITUMOR ACTIVITY OF VEPDEGESTRANT (ARV-471 /PF-07850327), AN ORAL PROTEOLYSIS TARGETING CHIMERA, IN COMBINATION WITH OTHER ANTICANCER TREATMENTS IN PARTICIPANTS AGED 18 YEARS AND OVER WITH ER+ ADVANCED OR METASTATIC BREAST CANCER, SUB-STUDY B (ARV-471 IN COMBINATION WITH RIBOCICLIB)
Protocol code: C4891023
Sponsor: Pfizer Inc. (Pharmaceutical company). Phase: Phase I and Phase II (Integrated)- Other. Countries: Spain (ongoing, recruitment ended), Italy (ended).
Therapeutic area(s): Diseases [C] - Neoplasms [C04]
Gender: Female, Male. Age: 18-64 years, 65+ years. Enrolment: 18.
Start date (EU): 2024-01-02. Decision date: 2023-08-14. Results received: No. Last updated: 2026-05-08.
Decision dates by country: IT: 2023-08-14, ES: 2023-08-14

Condition(s): ER+/HER2- Advanced or Metastatic Breast Cancer
Product: Kisqali 200 mg film-coated tablets, Kisqali 200 mg film-coated tablets, PF-07850327 round, Kisqali 200 mg film-coated tablets

Primary endpoint: Phase 1b: DLTs during DLT observation period (Cycle 1)., Fase 2: Confirmed OR (CR or PR) determined by investigator assessment., DDI Assessment Cohort(s): Steady-state AUCtau and Cmax of ribociclib with and without co-administration of ARV-471.
Endpoint(s): Phase 1b and Phase 2: AEs as characterized by type, frequency, intensity as graded by NCI CTCAE version 5.0, timing, seriousness, and relationship to ARV-471 in combination with ribociclib. •Laboratory test abnormalities as characterized by type, frequency, intensity (as graded by NCI CTCAE version 5.0), and timing., Fase 1b: Confirmed OR (CR or PR) by investigator assessment. · DoR by investigator assessment. · CBR (confirmed CR or PR at any time, or SD ≥24 weeks) by investigator assessment. · PFS by investigator assessment. Phase 2: DoR by investigator assessment. · CBR (confirmed CR or PR at any time or SD ≥24 weeks) by investigator assessment. · PFS by investigator assessment. · OS., Phase 1b and Phase 2: Plasma concentrations of ARV-471, ARV-473, and ribociclib., Phase 1b: AUCtau and Cmax of ARV-471 with and without co-administration of ribociclib., Phase 2: ctDNA plasma quantitative changes from pre-treatment to evaluate potential predictability of their associations with clinical outcomes., DDI Assessment Cohort(s): - Incidence of AEs and SAEs. - Incidence of laboratory abnormalities. - Incidence of ECG abnormalities.

Source: https://euclinicaltrials.eu/ctis-public/view/2022-502231-19-00